EU clinical trial 2023-504127-90-00: An Open-Label Extension for Subjects in Studies HGT-HIT-046 and SHP609-302 Evaluating Long-Term Safety of Intrathecal Idursulfase-IT Administered in Conjunction with Intravenous Elaprase® in Subjects with Hunter Syndrome and Cognitive Impairment
Protocol code: TAK-609-3001
Sponsor: Takeda Development Center Americas Inc. (Pharmaceutical company). Phase: Therapeutic confirmatory (Phase III). Countries: France (ongoing, recruiting).
Therapeutic area(s): Diseases [C] - Congenital, Hereditary, and Neonatal Diseases and Abnormalities [C16]
Gender: Male. Age: 0-17 years. Enrolment: 4.
Status: Ongoing, recruiting. Start date (EU): 2024-04-08. Decision date: 2024-02-13. Results received: No. Last updated: 2026-02-12.

Condition(s): Hunter Syndrome and Cognitive Impairment
Product: Idursulfase (idursulfase-IT [HGT-2310])

Primary endpoint: 01. The primary endpoint of this study is the safety of intrathecal idursulfase-IT administration. Safety will be assessed by AEs (by type, severity, and relationship to treatment [idursulfase-IT, the IDDD, device surgical procedure, or IT administration process] and IV Elaprase infusion).

Source: https://euclinicaltrials.eu/ctis-public/view/2023-504127-90-00